EU clinical trial 2025-522921-37-00: An open-label, randomized, single-dose, two-period, two-treatment, crossover bioequivalence study with GP-IMP-001 in healthy male volunteers under fasting conditions.
Sponsor: Gebro Pharma GmbH (Pharmaceutical company). Phase: Human Pharmacology (Phase I)- Bioequivalence Study. Countries: Czechia (ended).
Therapeutic area(s): Diseases [C] - Skin and Connective Tissue Diseases [C17]; Diseases [C] - Digestive System Diseases [C06]
Gender: Male. Age: 18-64 years. Enrolment: 36.
Status: Ended. Start date (EU): 2025-10-22. End date (EU): 2026-01-06. Decision date: 2025-09-11. Results received: No. Last updated: 2025-09-11.

Condition(s): inteneded for treatment of - active rheumatoid arthritis in adult patients, - polyarthritic forms of severe, active juvenile idiopathic arthritis, when the response to nonsteroidal anti-inflammatory drugs has been inadequate, - severe recalcitrant disabling psoriasis which is not adequately responsive to other forms of therapy and severe psoriatic arthritis in adult patients, - mild-to-moderate Crohn’s disease, either alone or in combination with corticosteroids, in adult patients refractory or intolerant to thiopurines.

Source: https://euclinicaltrials.eu/ctis-public/view/2025-522921-37-00